EU clinical trial 2024-515354-24-00: COMBOLA Trial: A randomized phase I/ II multicenter study evaluating combination of luspatercept in LR-MDS without RS having failed or being ineligible to ESA
Protocol code: COMBOLA
Sponsor: Groupe Francophone Des Myelodysplasies (Patient organisation/association). Phase: Phase I and Phase II (Integrated)- Other. Countries: France (ongoing, recruiting), Italy (ongoing, recruiting).
Therapeutic area(s): Diseases [C] - Hemic and Lymphatic Diseases [C15]
Gender: Female, Male. Age: 18-64 years, 65+ years. Enrolment: 160.
Status: Ongoing, recruiting. Start date (EU): 2022-05-18. Decision date: 2024-10-18. Results received: No. Last updated: 2026-08-03.
Decision dates by country: FR: 2024-10-18, IT: 2025-12-23

Condition(s): Low risk myelodysplastic syndrom without RS having failed or being ineligible to Erythroid Stimulating Agent
Product: Reblozyl 75 mg powder for solution for injection, EPREX 40000 UI/ml, solution injectable en seringue préremplie, Reblozyl 25 mg powder for solution for injection

Primary endpoint: Part A : The dose finding study aims at determining the optimal dose (OD) that is both tolerable and has an indication of therapeutic benefit for those patients. It will use both toxicity and efficacy binary outcomes: Dose limiting toxicity (DLT), with an observation period up to day 42 of cycle 1 ; Efficacy: Treatment response will be defined at day 21 of cycle 1 by an increase in hemoglobin level of 1.5 g/dl or above., Part B: Erythroide response (HI-E) according to IWG2018 criteria at week 25 following randomization
Endpoint(s): Duration of response, Progression-free-survival, Overall survival

Source: https://euclinicaltrials.eu/ctis-public/view/2024-515354-24-00